EU clinical trial 2024-516098-62-00: CONDYVAC. Efficacy study of the quadrivalent Human Papilloma Virus (HPV) vaccine to prevent recurrence of External Genital Warts (EGW) in patients who were cured in the first place
Protocol code: P150957
Sponsor: Assistance Publique Hopitaux De Paris (Hospital/Clinic/Other health care facility). Phase: Therapeutic confirmatory (Phase III). Countries: France (ended).
Therapeutic area(s): Diseases [C] - Virus Diseases [C02]; Diseases [C] - Male Urogenital Diseases [C12]; Diseases [C] - Skin and Connective Tissue Diseases [C17]; Diseases [C] - Female Urogenital Diseases and Pregnancy Complications [C13]
Gender: Female, Male. Age: 18-64 years, 65+ years. Enrolment: 300.
Status: Ended. Start date (EU): 2018-01-11. End date (EU): 2025-11-04. Decision date: 2024-12-10. Results received: No. Last updated: 2024-12-10.

Condition(s): External Genital Warts (EGW)
Product: Gardasil 9 suspension for injection in a pre-filled syringe. Human Papillomavirus 9-valent Vaccine (Recombinant, adsorbed), Gardasil, suspension for injection in a pre-filled syringe Human Papillomavirus Vaccine [Types 6, 11, 16, 18] (Recombinant, adsorbed), SODIUM CHLORIDE

Primary endpoint: Relapse-free “survival”. Relapse will have to be clinically confirmed.
Endpoint(s): Percentage of patients with local and/or systemic reactions during the study

Source: https://euclinicaltrials.eu/ctis-public/view/2024-516098-62-00